EU clinical trial 2025-522768-33-00: Is [18F]-DPA-714 PET a good marker of neuroinflammation in autoimmune encephalitis? (EAI-714)
Protocol code: RC31/24-0569
Sponsor: Centre Hospitalier Universitaire De Toulouse (Hospital/Clinic/Other health care facility). Phase: Therapeutic exploratory (Phase II). Countries: France (ongoing, recruiting).
Therapeutic area(s): Diseases [C] - Nervous System Diseases [C10]
Gender: Female, Male. Age: 18-64 years, 65+ years. Enrolment: 20.
Status: Ongoing, recruiting. Start date (EU): 2026-03-31. Decision date: 2025-12-15. Results received: No. Last updated: 2025-12-15.

Condition(s): autoimmune encephalitis
Product: 18F-DPA-714

Primary endpoint: The primary endpoint will be the value of the «Binding Potential» (BP) of DPA-714 at the whole brain scale calculated by an automated clustering method in supervised cluster analysis (SVCA).
Endpoint(s): The BPs of regions of interest will be compared between patients and controls., The result of imaging [18F]-DPA-714 in PET will be, for each participant, dichotomized into 2: positive and negative. A result will be classified as "positive" if at least one region of interest has a BP greater than 2-DS compared to the average of control participants as done in the study by Zhang et al., 2024. The percentage of patients with a positive result will be calculated., The results of other biomarkers conventionally used for the diagnosis of AIE will also be divided into 'positive' and 'negative'. Patients will be classified into positive/negative according to each biomarker to identify the most effective biomarker., Finally, a linear regression analysis will be performed between the overall BP of patients and clinical severity scores, We will make a description of a possible concordance between the BP by region of interest and the presence of identified symptoms

Source: https://euclinicaltrials.eu/ctis-public/view/2025-522768-33-00